EU clinical trial 2023-510428-55-00: A Randomized, Dose-Finding and Confirmatory, Double-Blind, Placebo-Controlled, Parallel-Group Multicenter Study With a 2-Stage Adaptive Design and Randomized Withdrawal to Evaluate the Efficacy, Safety, and Tolerability of Brivaracetam as Monotherapy in Patients 2 to 25 Years of Age With Childhood Absence Epilepsy or Juvenile Absence Epilepsy
Protocol code: N01269
Sponsor: UCB Biopharma (Pharmaceutical company). Phase: Phase II and Phase III (Integrated). Countries: Spain (ended), Slovakia (ended), Romania (ended), Italy (ended).
Therapeutic area(s): Diseases [C] - Nervous System Diseases [C10]
Gender: Female, Male. Age: 0-17 years, 18-64 years. Enrolment: 107.
Status: Ended. Start date (EU): 2022-03-10. End date (EU): 2026-03-04. End date: 2026-07-07. Decision date: 2024-05-21. Results received: No. Last updated: 2026-03-05.
Decision dates by country: ES: 2024-05-22, SK: 2024-05-21, RO: 2024-05-24, IT: 2024-06-18

Condition(s): Childhood Absence Epilepsy Juvenile Absence Epilepsy
Product: brivaracetam, brivaracetam, brivaracetam, Placebo matching < brivaracetam oral solution> and without active substance

Primary endpoint: Percentage of participants who met the criteria for absence seizure freedom within 4 days prior to or during the 24-hour ambulatory electroencephalogram (EEG) at Day 14
Endpoint(s): 1. Percentage of participants who met the criteria for absence seizure freedom during the randomized withdrawal (RDW) period as determined by electroencephalogram (EEG), 2. Percent change from Baseline to Day 14 in number of absence seizures on 24-hour ambulatory electroencephalogram (EEG), 3. Percentage of participants who met the criteria for absence seizure freedom based on diary during the 4 days prior to the visit at Day 14, 4. Percentage of participants who met the criteria for absence seizure freedom on 24-hour ambulatory electroencephalogram (EEG) at Week 12, 5. Percentage of participants who met the criteria for absence seizure freedom based on diary during the 4 days prior to the visit at Week 12, 6. Percentage of participants with treatment-emergent adverse events (TEAEs) during the study, 7. Percentage of participants with treatment-emergent adverse events (TEAEs) leading to discontinuation of study treatment, 8. Percentage of participants with serious adverse events (SAEs) during the study, 9. Percentage of participants with drug-related treatment-emergent adverse events (TEAEs) during the study

Source: https://euclinicaltrials.eu/ctis-public/view/2023-510428-55-00